EU clinical trial 2023-504450-35-00: A Phase I (First-in-Human) Randomized, Double-Blind, Placebo-Controlled Study to Investigate the Safety, Tolerability, Pharmacokinetics, and Pharmacodynamics of CAN10, an Anti-IL1RAP Monoclonal Antibody, in Healthy Subjects and in Subjects with Mild to Moderate Plaque Psoriasis
Protocol code: CAN10CLIN001
Sponsor: Otsuka Pharmaceutical Development & Commercialization Inc. (Pharmaceutical company). Phase: Human Pharmacology (Phase I)- First administration to humans. Countries: Germany (ended).
Therapeutic area(s): Diseases [C] - Immune System Diseases [C20]
Gender: Female, Male. Age: 18-64 years. Enrolment: 112.
Status: Ended. Start date (EU): 2023-08-21. End date (EU): 2025-11-10. End date: 2025-11-11. Decision date: 2023-08-10. Results received: No. Last updated: 2025-12-18.

Condition(s): Plaque psoriasis

Source: https://euclinicaltrials.eu/ctis-public/view/2023-504450-35-00